EU clinical trial 2025-521712-19-00: AndroMETa-CRC-560: An Open-Label, Randomized, Controlled, Global Phase 3 Study Comparing Telisotuzumab Adizutecan (ABBV-400) plus Bevacizumab to LONSURF (Trifluridine and Tipiracil) plus Bevacizumab in Subjects with Refractory Metastatic Colorectal Cancer
Protocol code: M24-560
Sponsor: AbbVie Deutschland GmbH & Co. KG (Pharmaceutical company). Phase: Therapeutic confirmatory (Phase III). Countries: Greece (ongoing, recruiting), Portugal (ongoing, recruiting), Germany (authorised, recruitment pending), Belgium (ongoing, recruiting), Spain (ongoing, recruiting).
Therapeutic area(s): Diseases [C] - Neoplasms [C04]
Gender: Female, Male. Age: 18-64 years, 65+ years. Enrolment: 243.
Start date (EU): 2026-07-06. Decision date: 2026-06-29. Results received: No. Last updated: 2026-07-17.
Decision dates by country: DE: 2026-07-06, GR: 2026-07-02, PT: 2026-06-30, ES: 2026-07-06, BE: 2026-07-17

Condition(s): Colorectal Cancer
Product: TRIFLURIDINE, COMBINATIONS, BEVACIZUMAB, Telisotuzumab adizutecan, Telisotuzumab adizutecan, BEVACIZUMAB

Primary endpoint: Phase 3: Objective Response (OR) as assessed by Blinded Independent Central Review (BICR), Phase 3: Overall Survival (OS)
Endpoint(s): Phase 3: Progression-Free Survival (PFS) Assessed by Blinded Independent Central Review (BICR), Phase 3: Duration Of Response (DoR) as assessed by BICR, Phase 3: Disease Control (DC) as assessed by BICR:, Phase 3: Change from baseline in the EORCT QLQ-C30 physical functioning domain at Week 13, Phase 3: Change from baseline in the remaining EORCT QLQ-C30 domains

Source: https://euclinicaltrials.eu/ctis-public/view/2025-521712-19-00